EU clinical trial 2024-510691-20-00: FIREFLY-1: A Phase 2, Open-Label, Multicenter Study to Evaluate the Safety and Efficacy of the Oral Pan-RAF Inhibitor DAY101 in Pediatric Patients with RAF-Altered, Recurrent or Progressive Low-Grade Glioma and Advanced Solid Tumors
Protocol code: DAY101-001
Sponsor: Day One Biopharmaceuticals Inc. (Pharmaceutical company). Phase: Therapeutic exploratory (Phase II). Countries: Denmark (ongoing, recruiting), Netherlands (ongoing, recruiting), Germany (ongoing, recruiting).
Therapeutic area(s): Diseases [C] - Neoplasms [C04]
Gender: Female, Male. Age: 0-17 years, 18-64 years. Enrolment: 16.
Status: Ongoing, recruiting. Start date (EU): 2021-09-23. Decision date: 2024-07-29. Results received: No. Last updated: 2025-07-21.
Decision dates by country: DE: 2024-08-01, DK: 2024-07-31, NL: 2024-07-29

Condition(s): RAF-Altered, Recurrent or Progressive Low-Grade Glioma and Advanced Solid Tumors in pediatric patients
Product: Tovorafenib, Tovorafenib

Primary endpoint: Arm 1 (Low-Grade Glioma): ORR by RANO-HGG criteria; Arm 2 (Low-Grade Glioma Extension): Type, frequency, and severity of adverse events (AEs) and laboratory abnormalities; Arm 3 (Advanced Solid Tumor): Measured by the proportion of patients with best overall confirmed response of complete response (CR) or partial response (PR) by RECIST v1.1 or RANO-HGG criteria
Endpoint(s): Arm 1 (Low-Grade Glioma): Type, frequency, and severity of AEs and laboratory abnormalities; -Pharmacokinetic profile of DAY101 (e.g., area under the concentration-time curve [AUC], Cmin, etc.); Time following initiation of DAY101 to progression or death in patients treated with DAY101 - length of response in patients with best overall confirmed response of CR or PR; Time to first response following initiation of DAY101 in patients with best overall confirmed response of CR or PR, Arm 2 (Low-Grade Glioma Extension): -Measured by the proportion of patients with best overall confirmed response of CR or PR as determined by the RANO criteria; Measured by the proportion of patients with best overall confirmed response of CR or PR by RAPNO–low-grade glioma criteria, Arm 3 (Advanced Solid Tumor): Type, frequency, and severity of AEs and laboratory abnormalities; Pharmacokinetic profile of DAY101 (e.g., AUC, Cmin, etc.)

Source: https://euclinicaltrials.eu/ctis-public/view/2024-510691-20-00